EU clinical trial 2024-516423-14-00: A relative bioavailability study between a fixed dose combination product of Ibuprofen and Paracetamol vs. free combination of Ibuprofen and Paracetamol
Protocol code: BECRO/BF/BIOFEN
Sponsor: Biofarm S.A. (Pharmaceutical company). Phase: Human Pharmacology (Phase I)- Bioequivalence Study. Countries: Greece (ended).
Therapeutic area(s): Diseases [C] - Pathological Conditions, Signs and Symptoms [C23]; Diseases [C] - Musculoskeletal Diseases [C05]
Gender: Female, Male. Age: 18-64 years. Enrolment: 32.
Status: Ended. Start date (EU): 2024-12-19. End date (EU): 2025-02-21. Decision date: 2024-11-20. Results received: No. Last updated: 2024-11-20.

Condition(s): cold and flu, pain, fever

Source: https://euclinicaltrials.eu/ctis-public/view/2024-516423-14-00